EU clinical trial 2025-521764-35-01: A prospective, randomised, multi-centre, double-blind, placebo-controlled Phase III trial to investigate the efficacy and safety of lozenges with benzydamine hydrochloride and dichlorobenzyl alcohol in the symptomatic treatment of patients suffering from acute pharyngitis
Protocol code: 6630-9450-01
Sponsor: MEDICE Arzneimittel Puetter GmbH & Co. KG (Pharmaceutical company). Phase: Therapeutic confirmatory (Phase III). Countries: Germany (temporarily halted).
Therapeutic area(s): Diseases [C] - Otorhinolaryngologic Diseases [C09]
Gender: Female, Male. Age: 18-64 years, 65+ years. Enrolment: 810.
Status: Temporarily halted. Start date (EU): 2026-01-27. Decision date: 2025-12-11. Results received: No. Last updated: 2026-07-22.

Condition(s): acute pharyngitis
Product: Mebocaína Anti-Inflam, 1.2 mg + 3 mg, comprimidos para chupar, DoriDuo, Placebo to Test and Comparator

Primary endpoint: Superiority of IMP 1 in comparison to IMP 3 (Placebo) and for non-inferiority of IMP 1 in comparison to IMP 2 (reference) and is defined as area Under Curve (AUC) of changes from Baseline in Throat Soreness Intensity Scale (TSS) over the time course of 2 hours after first application on Day 0

Source: https://euclinicaltrials.eu/ctis-public/view/2025-521764-35-01